EU clinical trial 2023-507017-10-00: A Phase 1b, Open-Label, Single-Arm Study to Assess the Safety, Tolerability, Pharmacokinetics, Pharmacodynamics and Clinical Effect of ANX1502 in Participants with Primary Cold Agglutinin Disease
Protocol code: ANX1502-CAD-02
Sponsor: Annexon Inc. (Pharmaceutical company). Phase: Human Pharmacology (Phase I)- Other. Countries: Austria (ended).
Therapeutic area(s): Diseases [C] - Immune System Diseases [C20]
Gender: Female, Male. Age: 18-64 years, 65+ years. Enrolment: 10.
Status: Ended. Start date (EU): 2024-06-17. End date (EU): 2025-12-05. End date: 2026-06-07. Decision date: 2023-11-13. Results received: No. Last updated: 2025-11-10.

Condition(s): Primary Cold Agglutinin Disease (CAD)

Source: https://euclinicaltrials.eu/ctis-public/view/2023-507017-10-00